EU clinical trial 2024-516270-30-00: Safety Outcomes Post Kidney Biopsy – randomized clinical Evaluation of Efficacy of Desmopressin
Protocol code: 2021/ABM/01/00010
Sponsor: Medical University Of Bialystok (Educational Institution). Phase: Therapeutic confirmatory (Phase III). Countries: Poland (ended).
Therapeutic area(s): Not possible to specify
Gender: Female, Male. Age: 18-64 years, 65+ years. Enrolment: 454.
Status: Ended. Start date (EU): 2022-08-25. End date (EU): 2025-10-01. Decision date: 2024-12-02. Results received: No. Last updated: 2024-12-02.

Condition(s): Rare and ultra-rare glomerulonephritis
Product: Placebo, Minirin, 4 mikrogramy/ml, roztwór do wstrzykiwań

Primary endpoint: Efficacy primary outcome: Number of major and minor bleeding events in 24 h after the procedure which is defined as: • minor bleeding events: macroscopic haematuria; clinically silent hematoma in ultrasound in 24h after biopsy, decrease in haemoglobin concentration >20% in regards to initial values. • Major bleeding events: transfusion of red cells concentrate, embolisation, nephrectomy, bleeding related directly and indirectly death., Safety primary outcome: Hyponatremia 24 and 48 h after biopsy
Endpoint(s): Efficacy secondary outcome: Hospitalization time from kidney biopsy till discharge, Efficacy secondary outcome: Cost-effectiveness analysis of desmopressin use, Safety secondary outcome Frequency of AEs of special interest: • Tachycardia HR>100 BPM • Hypotension defined as SBP <90 mmHg or MAP <65 mgHg or a systolic blood pressure decrease of 40 mmHg. • Any thrombotic events

Source: https://euclinicaltrials.eu/ctis-public/view/2024-516270-30-00